EU clinical trial 2024-517816-31-00: IMMUNOGAST: An umbrella phase 2 trial to assess personalized targeted IMMUNOtherapy-based regimens in recurrent advanced/metastatic GASTric adenocarcinoma patients
Sponsor: Hospices Civils De Lyon (Hospital/Clinic/Other health care facility). Phase: Therapeutic exploratory (Phase II). Countries: France (ended).
Therapeutic area(s): Diseases [C] - Neoplasms [C04]
Gender: Female, Male. Age: 18-64 years, 65+ years. Enrolment: 54.
Status: Ended. Start date (EU): 2021-03-19. End date (EU): 2026-06-04. Decision date: 2024-11-17. Results received: No. Last updated: 2026-04-02.

Condition(s): For patients with advanced/metastatic gastric adenocarcinomas in progression

Source: https://euclinicaltrials.eu/ctis-public/view/2024-517816-31-00